EU clinical trial 2023-504257-12-00: Randomised, open-label and parallel group trial to investigate the effects of oral BI 685509 alone or in combination with empagliflozin on portal hypertension after 8 weeks treatment in patients with clinically significant portal hypertension (CSPH) in compensated cirrhosis
Protocol code: 1366-0029
Sponsor: Boehringer Ingelheim International GmbH, Boehringer Ingelheim Espana S.A., Boehringer Ingelheim RCV GmbH & Co. KG (Industry, Pharmaceutical company, Pharmaceutical company). Phase: Therapeutic exploratory (Phase II). Countries: Spain (ended), Austria (ended), Netherlands (ended), Germany (ended), Denmark (ended), France (ended), Italy (ended), Belgium (ended), Romania (ended).
Therapeutic area(s): Diseases [C] - Cardiovascular Diseases [C14]
Gender: Female, Male. Age: 18-64 years, 65+ years. Enrolment: 62.
Status: Ended. Start date (EU): 2022-07-28. End date (EU): 2024-05-31. Decision date: 2023-05-24. Results received: Yes. Last updated: 2024-04-24.
Decision dates by country: DE: 2023-05-31, DK: 2023-05-24, RO: 2023-09-21, FR: 2023-05-26, NL: 2023-05-24, ES: 2023-05-24, BE: 2023-06-15, AT: 2023-05-25, IT: 2023-06-09

Condition(s): Portal hypertension
Product: EMPAGLIFLOZIN, BI 685509, BI 685509, BI 685509

Primary endpoint: The primary endpoint is the percentage change in HVPG from baseline (measured in mmHg) after 8 weeks of treatment.
Endpoint(s): Occurrence of a response, which is defined as > 10% reduction from baseline HVPG (measured in mmHg) after 8 weeks of treatment, Occurrence of one or more decompensation events (i.e. ascites, VH, and / or overt HE) during the 8-week treatment period, Occurrence of CTCAE grade 3 (or higher) hypotension or syncope based on Investigator judgement, during the 8-week treatment period, Occurrence of discontinuation due to hypotension or syncope during the 8-week treatment period

Source: https://euclinicaltrials.eu/ctis-public/view/2023-504257-12-00